EU clinical trial 2023-510390-33-00: Phase III postneoadjuvant study evaluating Sacituzumab Govitecan, an Antibody Drug Conjugate in primary HER2-negative breast cancer patients with high relapse risk after standard neoadjuvant treatment - SASCIA
Protocol code: GBG102-SASCIA
Sponsor: GBG Forschungs GmbH (Hospital/Clinic/Other health care facility). Phase: Therapeutic confirmatory (Phase III). Countries: Spain (ongoing, recruitment ended), Ireland (ongoing, recruitment ended), France (ongoing, recruitment ended), Germany (ongoing, recruitment ended), Austria (ongoing, recruitment ended), Belgium (ongoing, recruitment ended).
Therapeutic area(s): Diseases [C] - Neoplasms [C04]
Gender: Female, Male. Age: 18-64 years, 65+ years. Enrolment: 1386.
Status: Ongoing, recruitment ended. Start date (EU): 2020-10-23. Decision date: 2024-08-20. Results received: No. Last updated: 2026-03-09.
Decision dates by country: AT: 2024-08-26, FR: 2024-08-26, ES: 2024-08-20, BE: 2024-08-22, DE: 2024-09-03, IE: 2024-08-20

Condition(s): HER2-negative breast cancer patients with high relapse risk after standard neoadjuvant treatment, HER2-negative breast cancer
Product: Carbomedac® 10 mg/ml Konzentrat zur Herstellung einer Infusionslösung, Cisplatin NeoCorp 1 mg/ml - Konzentrat zur Herstellung einer Infusionslösung, Xeloda 500 mg film-coated tablets, Trodelvy 200 mg powder for concentrate for solution for infusion, Xeloda 150 mg film-coated tablets

Primary endpoint: iDFS is defined as time from randomization until first iDFS event: local invasive recurrence following mastectomy, local invasive recurrence in the ipsilateral breast following lumpectomy, regional recurrence, distant recurrence, contralateral invasive breast cancer, second non-breast primary cancer (excluding squamous or basal cell carcinoma of the skin), or death from any cause.
Endpoint(s): OS is defined as the time from randomization until death from any cause., DDFS is defined as the time from randomization until distant recurrence of disease, second primary invasive cancer (non-breast, excluding squamous or basal cell carcinoma of the skin), and death due to any cause., iBCFS is defined as the time from randomization until first iDFS event excluding any second non-breast primary cancer., LRRFI is defined as the time from randomization until any loco-regional (ipsilateral breast (invasive), chest wall, local/regional lymph nodes) recurrence of disease or any invasive contralateral breast cancer whichever occurs first. Distant recurrence, secondary malignancy and death are considered as competing risks and will be accounted for in the analysis., Frequency and severity of adverse events graded according to the NCI Common Terminology Criteria for Adverse Events (CTCAE) version 5.0., Dose-density, dose reductions, dose delays, treatment interruptions and treatment discontinuation rates., Patient reported breast cancer specific QoL as measured by FACT–B; functional assessment of cognitive function assessed by FACT-Cog; patient reported global QoL assessed by EQ-5D-5L.

Source: https://euclinicaltrials.eu/ctis-public/view/2023-510390-33-00